EU clinical trial 2024-513762-18-00: A Phase 2, Double-Blind, Randomized, Parallel Group Study Evaluating the Efficacy, Safety, and Tolerability of Obeticholic Acid Administered in Combination with Bezafibrate in Subjects with Primary Biliary Cholangitis Who Had an Inadequate Response or Who Were Unable to Tolerate Ursodeoxycholic Acid
Protocol code: 747-213
Sponsor: Intercept Pharmaceuticals Inc. (Pharmaceutical company). Phase: Therapeutic exploratory (Phase II). Countries: Germany (ended), Norway (ended), Hungary (ended), Spain (ended), Belgium (ended), Croatia (ended), Czechia (ended), Netherlands (ended), Lithuania (ended), France (ended), Estonia (ended), Greece (ended).
Therapeutic area(s): Diseases [C] - Digestive System Diseases [C06]
Gender: Female, Male. Age: 18-64 years, 65+ years. Enrolment: 65.
Status: Ended. Start date (EU): 2019-09-20. End date (EU): 2025-10-14. End date: 2025-10-15. Decision date: 2024-06-14. Results received: No. Last updated: 2025-07-18.
Decision dates by country: NO: 2024-06-14, ES: 2024-06-14, GR: 2024-07-19, BE: 2024-06-14, DE: 2024-06-18, NL: 2024-06-14, FR: 2024-06-19, LT: 2024-07-17, EE: 2024-06-18, CZ: 2024-06-17, HU: 2024-06-14, HR: 2024-06-17

Condition(s): Primary Biliary Cholangitis (PBC)
Product: OCALIVA, Placebo for Bezafibrate, Bezalip Mono, Placebo for Obeticholic Acid, Bezalip, OCALIVA

Primary endpoint: Change in ALP from baseline to Week 12 in the DB Period
Endpoint(s): The response rates of ≥10%, ≥20%, ≥30%, and ≥40% reduction from baseline and normalization rates of ALP at Week 12, Normalization rates at Week 12 of GGT, ALT, AST, ALP, total and conjugated bilirubin, and a lipid panel, Change from baseline to Week 12 in GGT, ALT, AST, and total and conjugated bilirubin, and a lipid panel, Change from baseline to Week 12 in 7α-hydroxy-4-cholesten-3-one (C4) and bile acids

Source: https://euclinicaltrials.eu/ctis-public/view/2024-513762-18-00